EU clinical trial 2022-503006-20-00: A Randomized, Double-blind, Parallel-group, Placebo-controlled, Fixed-dose, Multicenter Study to Evaluate the Efficacy and Safety of SEP-363856 in Acutely Psychotic Patients with Schizophrenia, Followed by an Open-label Extension Phase
Protocol code: DA801201
Sponsor: Sumitomo Pharma Co. Ltd. (Pharmaceutical company). Phase: Phase II and Phase III (Integrated). Countries: Romania (ended).
Therapeutic area(s): Psychiatry and Psychology [F] - Mental Disorders [F03]
Gender: Female, Male. Age: 18-64 years, 65+ years. Enrolment: 32.
Status: Ended. End date (EU): 2023-10-02. End date: 2024-02-15. Decision date: 2023-08-11. Results received: Yes. Last updated: 2023-08-11.

Condition(s): Acutely Psychotic Patients with Schizophrenia
Product: SEP-363856, SEP-363856 matching placebo, SEP-363856

Primary endpoint: Primary Efficacy Endpoint: Change from Baseline in PANSS total score at Week 6
Endpoint(s): Efficacy Endpoint: Secondary Efficacy Endpoint: Change from Baseline in CGI-S score at Week 6

Source: https://euclinicaltrials.eu/ctis-public/view/2022-503006-20-00